EU clinical trial 2023-507820-22-00: A Phase 1 Study of CD19-targeted NEX-T CAR T Cells in Participants with RMS, PMS, or MG(Breakfree-2)
Protocol code: CA061-1006
Sponsor: Celgene Corp. (Pharmaceutical company). Phase: Human Pharmacology (Phase I)- Other. Countries: Germany (temporarily halted), Belgium (temporarily halted), France (temporarily halted), Spain (temporarily halted).
Therapeutic area(s): Diseases [C] - Immune System Diseases [C20]
Gender: Female, Male. Age: 18-64 years. Enrolment: 56.
Status: Temporarily halted. Start date (EU): 2024-05-22. Decision date: 2024-05-02. Results received: No. Last updated: 2026-06-19.
Decision dates by country: FR: 2024-05-03, ES: 2024-05-06, DE: 2024-05-03, BE: 2024-05-02

Condition(s): Progressive Multiple Sclerosis (PMS), Myasthenia gravis (MG), Relapsing Multiple Sclerosis (RMS)

Source: https://euclinicaltrials.eu/ctis-public/view/2023-507820-22-00